EU clinical trial 2024-514434-20-00: A Phase 3 Global, Double-Blind, Randomized, Placebo-Controlled Study to Evaluate the Efficacy and Safety of ION-682884 in Patients with Transthyretin-Mediated Amyloid Cardiomyopathy (ATTR-CM)
Protocol code: ION-682884-CS2
Sponsor: Ionis Pharmaceuticals Inc. (Pharmaceutical company). Phase: Therapeutic confirmatory (Phase III). Countries: Czechia (ended), Portugal (ended), Sweden (ended), Greece (ended), Belgium (ended), Denmark (ended), Spain (ended), Austria (ended), France (ended), Germany (ongoing, recruitment ended), Poland (ended), Italy (ongoing, recruitment ended).
Therapeutic area(s): Diseases [C] - Cardiovascular Diseases [C14]
Gender: Female, Male. Age: 18-64 years, 65+ years. Enrolment: 413.
Start date (EU): 2020-06-29. Decision date: 2024-09-17. Results received: No. Last updated: 2026-03-11.
Decision dates by country: BE: 2024-09-18, PT: 2024-09-20, DK: 2024-09-20, PL: 2024-10-28, FR: 2024-09-27, GR: 2024-09-23, ES: 2024-09-17, DE: 2024-10-11, CZ: 2024-09-17, AT: 2024-09-29, SE: 2024-09-18, IT: 2024-10-16

Condition(s): Transthyretin-Mediated Amyloid Cardiomyopathy (ATTR-CM)
Product: ION 682884, Placebo injection, 0.8 ml (is a sterile, preservative-free, parenteral solution of sodium chloride and riboflavin in Water for Injection) for subcutaneous administration

Primary endpoint: Composite endpoint of CV-death and recurrent CV clinical events comparing the 2 study arms up to Week 140. Cardiovascular clinical events include: 1. Hospitalization for myocardial infarction (MI), Hospitalization for HF, Hospitalization for arrhythmia, Hospitalization for stroke/Transient Ischemic Attack TIA, HF urgent visits to ED/ER or HF clinics requiring administration of intravenous (IV) diuretics for improvement.

Source: https://euclinicaltrials.eu/ctis-public/view/2024-514434-20-00